EU clinical trial 2026-525590-40-00: Mass Balance and Absolute Oral Bioavailability of [14C]VH4524184
Protocol code: 223803
Sponsor: Viiv Healthcare UK Limited (Pharmaceutical company). Phase: Human Pharmacology (Phase I)- Other. Countries: Netherlands (ongoing, recruiting).
Therapeutic area(s): Diseases [C] - Immune System Diseases [C20]
Gender: Female, Male. Age: 18-64 years. Enrolment: 9.
Status: Ongoing, recruiting. Start date (EU): 2026-06-03. Decision date: 2026-05-18. Results received: No. Last updated: 2026-07-09.

Condition(s): human immunodeficiency virus (HIV)

Source: https://euclinicaltrials.eu/ctis-public/view/2026-525590-40-00